EU clinical trial 2022-502728-30-00: A study to test different doses of obrixtamig (BI 764532) combined with ezabenlimab in patients with Small Cell Lung Carcinoma and other neuroendocrine neoplasms expressing DLL3
Protocol code: 1438-0002
Sponsor: Boehringer Ingelheim International GmbH (Pharmaceutical company). Phase: Human Pharmacology (Phase I)- Other. Countries: Belgium (ongoing, recruitment ended), France (ongoing, recruitment ended), Germany (ongoing, recruitment ended).
Therapeutic area(s): Diseases [C] - Neoplasms [C04]
Gender: Female, Male. Age: 18-64 years, 65+ years. Enrolment: 37.
Status: Ongoing, recruitment ended. Start date (EU): 2023-08-25. Decision date: 2023-06-12. Results received: No. Last updated: 2026-03-19.
Decision dates by country: BE: 2023-06-12, FR: 2023-06-12, DE: 2023-06-12

Condition(s): Small Cell Lung Carcinoma expressing DLL3, Neuroendocrine carcinoma (NEC) or small cell carcinoma of any other origin expressing DLL3, Large cells neuroendocrine lung carcinoma (LCNEC) expressing DLL3

Source: https://euclinicaltrials.eu/ctis-public/view/2022-502728-30-00